EU clinical trial 2023-503919-15-00: Abemaciclib Plus Darolutamide in Prostate Cancer That Has Spread After Initial Treatment
Protocol code: I3Y-MC-JPEI
Sponsor: Eli Lilly & Co. (Pharmaceutical company). Phase: Human Pharmacology (Phase I)- Other. Countries: Spain (ended), Germany (ended).
Therapeutic area(s): Diseases [C] - Neoplasms [C04]
Gender: Male. Age: 18-64 years. Enrolment: 42.
Status: Ended. Start date (EU): 2024-01-09. End date (EU): 2026-01-21. Decision date: 2023-11-30. Results received: No. Last updated: 2026-02-12.
Decision dates by country: DE: 2023-12-04, ES: 2023-11-30

Condition(s): Prostatic Neoplasms

Source: https://euclinicaltrials.eu/ctis-public/view/2023-503919-15-00